EU clinical trial 2024-519779-24-00: GFM-VEXAS-MMB: A single-arm phase II with safety run-in multicenter study of momelotinib in patients with VEXAS syndrome with or without associated myelodysplastic syndrome
Protocol code: GFM-VEXAS-MMB
Sponsor: Groupe Francophone Des Myelodysplasies (Patient organisation/association). Phase: Therapeutic exploratory (Phase II). Countries: France (ongoing, recruiting).
Therapeutic area(s): Diseases [C] - Immune System Diseases [C20]
Gender: Female, Male. Age: 18-64 years, 65+ years. Enrolment: 57.
Status: Ongoing, recruiting. Start date (EU): 2025-11-25. Decision date: 2025-10-08. Results received: No. Last updated: 2026-01-08.

Condition(s): VEXAS (VACUOLES, E1 ENZYME, X-LINKED, AUTOINFLAMMATORY, SOMATIC) syndrome, Myelodysplastic syndrome

Primary endpoint: For Safety run-in : Documentation of dose-limiting toxicities (DLTs) and identification of a maximal tolerated dose (MTD). DLTs will be defined during a safety observation period corresponding to the first 4-week cycle of MMB. Because of the addition of a 4-week period to observe recovery of adverse events of interest, the observation window for DLT will be up to 8 weeks., For phase II : Overall clinical response rate at 24 weeks after MMB initiation on VEXAS related symptoms (including complete (CR) or partial response (PR))
Endpoint(s): For safety run-in: Adverse events (AE), serious AE (SAE) and toxicity as measured by NCI CTCAE v5.0, For safety run-in phase : Plasma MMB/M21 pharmacokinetic parameters (i.e. AUC, Cmax) as data permits, Overall clinical response rates (including CR or PR) and biological response rates (complete or partial) at 4, 12, 24 and 48 weeks after MMB initiation, Erythroid hematological improvement (HI-E) evaluated at 16 weeks according to IWG 2018, Steroids dose reduction compared to baseline and/or steroids withdrawal rates at 24 weeks, Overall survival at 12 months, Changes in the underlying MDS from baseline, at 12 and 24 weeks, including MDS progression based on hematological, cytogenetic and molecular analysis, Responses: 1-Duration of Response (DoR) on VEXAS symptoms defined as the time from the date of initial documentation of a clinical response (CR or PR) to the date of first documented evidence of relapse or death ; 2-Time to first and best clinical response ; 3-Duration of RBC independency in patients with RBC dependency at time of inclusion, according to IWG 2018 criteria, Evolution of UBA1 VAF on MMB, Adverse events (AE), serious AE (SAE) and toxicity as measured by NCI CTCAE v5.0, For ancillary study (biological end point): Evolution of UBA1 VAF from baseline to W4, W12 and W24, For ancillary study (Clinical end point): Evolution of VPSS from baseline to W4, W12 and W24

Source: https://euclinicaltrials.eu/ctis-public/view/2024-519779-24-00